EU clinical trial 2025-523949-10-00: A study in healthy men to test how BI 1815368 is processed in the body
Protocol code: 1485-0012
Sponsor: Boehringer Ingelheim International GmbH (Pharmaceutical company). Phase: Human Pharmacology (Phase I)- Other. Countries: Netherlands (ongoing, recruiting).
Therapeutic area(s): Not possible to specify
Gender: Male. Age: 18-64 years. Enrolment: 8.
Status: Ongoing, recruiting. Start date (EU): 2026-07-14. Decision date: 2026-06-30. Results received: No. Last updated: 2026-06-30.

Condition(s): Healthy volunteers trial

Source: https://euclinicaltrials.eu/ctis-public/view/2025-523949-10-00